EU clinical trial 2024-510784-36-00: A Phase II Study of Dasatinib Therapy in Children and Adolescents with Ph+ Leukemias Resistant or Intolerant to Imatinib.
Protocol code: CA180-226
Sponsor: Bristol Myers Squibb International Corporation (Pharmaceutical company). Phase: Phase I and Phase II (Integrated)- Other. Countries: France (ended), Spain (ended).
Therapeutic area(s): Diseases [C] - Neoplasms [C04]
Gender: Female, Male. Age: 0-17 years. Enrolment: 14.
Status: Ended. Start date (EU): 2009-04-27. End date (EU): 2024-10-25. End date: 2025-01-27. Decision date: 2024-05-03. Results received: Yes. Last updated: 2024-09-16.
Decision dates by country: FR: 2024-05-24, ES: 2024-05-03

Condition(s): Children and Adolescents with Newly Diagnosed Chronic Phase CML or with Ph+ Leukemias Resistant to or Intolerant to Imatinib
Product: DASATINIB, Dasatinib, dasatinib, dasatinib

Primary endpoint: Cohort #1: Major Cytogenetic Response (MCyR) rate, defined as the proportion of all treated subjects who achieve a complete or partial cytogenetic response on study., Cohort #2: Complete Hematologic Response (CHR) rate, defined as the proportion of all treated subjects who achieve a confirmed CHR on study.
Endpoint(s): Cohort #1: CHR rates, Cohort #2: MCyR rates, For all Cohorts: – Rates of best cytogenetic response – Time to Major Cytogenetic Response (McyR) and duration of and McyR – Time to Complete Hematologic Response (CHR) and duration of CHR – Progression-free Survival (PFS) and Disease free survival (DFS) – Overall Survival – Rates of major and complete molecular response

Source: https://euclinicaltrials.eu/ctis-public/view/2024-510784-36-00